EU clinical trial 2025-520754-11-00: Phase I, Open-Label Study to Evaluate the Pharmacokinetics, Safety and Tolerability of BIA 28-6156 in Participants with Varying Degrees of Renal Impairment
Protocol code: BIA-28-6156-111
Sponsor: Bial R&D Investments S.A. (Pharmaceutical company). Phase: Human Pharmacology (Phase I)- Other. Countries: Hungary (ended).
Therapeutic area(s): Diseases [C] - Nervous System Diseases [C10]
Gender: Female, Male. Age: 18-64 years, 65+ years. Enrolment: 40.
Status: Ended. Start date (EU): 2025-08-25. End date (EU): 2026-06-03. Decision date: 2025-08-22. Results received: No. Last updated: 2025-12-10.

Condition(s): Parkinson's disease

Source: https://euclinicaltrials.eu/ctis-public/view/2025-520754-11-00